EU clinical trial 2025-521503-43-00: A multicenter, randomized, participant- and investigator -blinded, placebo-controlled, phase 2a study to assess the efficacy, safety and tolerability of GIA632 in adult participants with moderate to severe atopic dermatitis
Protocol code: CGIA632A12201
Sponsor: Novartis Pharma AG (Pharmaceutical company). Phase: Therapeutic exploratory (Phase II). Countries: France (temporarily halted), Germany (temporarily halted), Poland (temporarily halted), Czechia (temporarily halted), Bulgaria (temporarily halted).
Therapeutic area(s): Diseases [C] - Skin and Connective Tissue Diseases [C17]
Gender: Female, Male. Age: 18-64 years, 65+ years. Enrolment: 52.
Status: Temporarily halted. Start date (EU): 2026-02-12. Decision date: 2026-01-14. Results received: No. Last updated: 2026-07-20.
Decision dates by country: CZ: 2026-01-15, FR: 2026-01-14, DE: 2026-01-15, PL: 2026-01-19, BG: 2026-03-04

Condition(s): Atopic dermatitis
Product: GIA632, Placebo to GIA632 150 mg/mL solution for injection

Primary endpoint: IGA response at week 16 defined as clear (0) or almost clear (1) score with at least a 2 point-reduction from baseline
Endpoint(s): Treatment-emergent adverse events (TEAEs) until End of Study (EoS)

Source: https://euclinicaltrials.eu/ctis-public/view/2025-521503-43-00